EU clinical trial 2024-517993-94-00: A Phase II Open-Label Randomized Controlled Pre-Surgical Feasibility Study of Antibiotic Combinations in Early Breast Cancer – ABC2
Protocol code: ABC2
Sponsor: Azienda Ospedaliero Universitaria Pisana (Hospital/Clinic/Other health care facility). Phase: Therapeutic exploratory (Phase II). Countries: Italy (authorised, recruitment pending).
Therapeutic area(s): Diseases [C] - Neoplasms [C04]
Gender: Female. Age: 18-64 years, 65+ years. Enrolment: 90.
Status: Authorised, recruitment pending. Decision date: 2024-11-19. Results received: No. Last updated: 2024-11-19.

Condition(s): Breast Cancer
Product: AZITROMICINA ZENTIVA 500 mg compresse rivestite con film, Bassado 100 mg compresse, CEBION

Primary endpoint: Reduction in Ki67 expression in post-treatment tumor core biopsies compared to pre-treatment tumor core biopsies (from the same patient). Post-treatment samples will also be compared with untreated samples.

Source: https://euclinicaltrials.eu/ctis-public/view/2024-517993-94-00